EU clinical trial 2023-510443-37-00: An Open-label, Single-arm, Multicenter Pilot Study to Evaluate the Pharmacokinetics, Pharmacodynamics, Efficacy and Safety of Pegcetacoplan in Patients with Transplant-associated Thrombotic Microangiopathy (TA-TMA) After Hematopoietic Stem Cell Transplantation (HSCT)
Protocol code: Sobi.PEGCET-201
Sponsor: Swedish Orphan Biovitrum AB (publ) (Pharmaceutical company). Phase: Therapeutic exploratory (Phase II). Countries: Spain (ended), France (ended), Italy (ended), Greece (ended).
Therapeutic area(s): Diseases [C] - Hemic and Lymphatic Diseases [C15]
Gender: Female, Male. Age: 18-64 years, 65+ years. Enrolment: 12.
Status: Ended. Start date (EU): 2022-01-26. End date (EU): 2024-12-08. End date: 2024-12-09. Decision date: 2024-05-27. Results received: Yes. Last updated: 2025-01-30.
Decision dates by country: FR: 2024-05-28, IT: 2024-06-03, ES: 2024-05-27, GR: 2024-06-28

Condition(s): Transplant-associated Thrombotic Microangiopathy (TA TMA)

Primary endpoint: Pegcetacoplan PK parameters: AUC0-tau, Cmax, Tmax and Ctrough.
Endpoint(s): PD endpoints: o Absolute levels, change from baseline, and % change from baseline to Week 24 in biomarkers of complement activation: sC5b-9, C3a, C3, Bb, C4a, functional assays for classical and alternative complement pathways., Clinical response at Week 24, defined as improvement in laboratory markers and in clinical status (renal, pulmonary, GI, Neurological responses, freedom from transfusion, cardiovascular and serositis responses). Patients meeting intercurrent events, including use of prohibited medication or study withdrawal before Week 24, will be considered as failures/nonresponders., TMA response at Week 24, defined as improvement in laboratory markers as follows: o LDH < 1.5 x ULN and o Platelet count ≥ 50 000/mm3 without transfusion support during the prior 7 days and o ≥ 50 % reduction from baseline in rUPCR., Overall survival at Day 100 from date of TA-TMA diagnosis., Overall survival at Week 24 from treatment start., Time to clinical response., Time to TMA response., Duration of clinical response., Duration of TMA response, TA-TMA relapse at Week 24., Clinical response at Week 12., TMA response at Week 12.

Source: https://euclinicaltrials.eu/ctis-public/view/2023-510443-37-00